EU clinical trial 2024-516321-31-00: A Phase 2, randomised, double-blind, placebo-controlled, 2-way crossover study to evaluate the efficacy, safety, and tolerability of NMD670 in ambulatory adults with Type 3 spinal muscular atrophy
Protocol code: NMD670-02-0001
Sponsor: NMD Pharma A/S (Pharmaceutical company). Phase: Therapeutic exploratory (Phase II). Countries: Netherlands (ended), Spain (ended), Belgium (ended), Denmark (ended), Germany (ended), Italy (ended).
Therapeutic area(s): Diseases [C] - Musculoskeletal Diseases [C05]
Gender: Female, Male. Age: 18-64 years, 65+ years. Enrolment: 69.
Status: Ended. Start date (EU): 2023-07-07. End date (EU): 2026-02-17. End date: 2026-05-18. Decision date: 2024-10-01. Results received: No. Last updated: 2025-10-24.
Decision dates by country: DE: 2025-01-27, ES: 2024-10-03, BE: 2024-10-01, IT: 2024-10-07, DK: 2024-10-02, NL: 2024-10-01

Condition(s): Type 3 spinal muscular atrophy
Product: Placebo 100 mg tablet, NMD670, Placebo 300 mg tablet, NMD670

Primary endpoint: Change from baseline in 6MWT (total distance) after 21-day dosing
Endpoint(s): Change from baseline in individual muscle groups maximum strength (measured with a dynamometer) after 21-day dosing. Change from baseline after 21-day dosing in: -6MWT (fatigue index), -revised Hammersmith scale score. Change from baseline in jitter and blocking measured via sfEMG after 21- day dosing. AEs, physical examinations, clinical laboratory parameters, vital signs, ECG, C-SSRS.

Source: https://euclinicaltrials.eu/ctis-public/view/2024-516321-31-00